EU clinical trial 2025-520980-41-00: Open label, single-center, cross-over randomized, relative bioavailability study comparing a new pitolisant hydrochloride tablet formulation versus the marketed pitolisant (Wakix®) tablet formulation after single oral administrations in healthy subjects.
Protocol code: P25-01
Sponsor: Bioprojet Pharma (Pharmaceutical company). Phase: Human Pharmacology (Phase I)- Other. Countries: Belgium (ended).
Therapeutic area(s): Diseases [C] - Nervous System Diseases [C10]
Gender: Female, Male. Age: 18-64 years. Enrolment: 16.
Status: Ended. Start date (EU): 2025-04-08. End date (EU): 2025-10-18. Decision date: 2025-03-06. Results received: No. Last updated: 2025-06-03.

Condition(s): narcolepsy with cataplexy, Narcolepsy

Source: https://euclinicaltrials.eu/ctis-public/view/2025-520980-41-00